EU clinical trial 2023-505205-16-00: A Multicentre, Phase II, Open-label Study to Evaluate the Efficacy of Acalabrutinib in Combination with Venetoclax and Rituximab in Participants with Treatment Naïve Mantle Cell Lymphoma (TrAVeRse)
Protocol code: D822GC00001
Sponsor: AstraZeneca AB (Pharmaceutical company). Phase: Therapeutic exploratory (Phase II). Countries: Spain (ongoing, recruitment ended), Poland (ongoing, recruitment ended).
Therapeutic area(s): Diseases [C] - Neoplasms [C04]
Gender: Female, Male. Age: 18-64 years, 65+ years. Enrolment: 41.
Status: Ongoing, recruitment ended. Start date (EU): 2024-02-21. Decision date: 2023-12-19. Results received: No. Last updated: 2025-07-18.
Decision dates by country: ES: 2023-12-19, PL: 2023-12-21

Condition(s): Treatment Naïve Mantle Cell Lymphoma
Product: Venclyxto 100 mg film-coated tablets, RITUXIMAB, Calquence 100 mg film-coated tablets, Venclyxto 50 mg film-coated tablets, RITUXIMAB, Venclyxto 10 mg film-coated tablets

Primary endpoint: MRD-negative CR rate
Endpoint(s): MRD-negative CR rate o MRD-negative CR rate is defined as the proportion of participants who achieved MRD-negativity in peripheral blood by NGS at a threshold of 10-5 while in CR per the Lugano Classification for NHL at any time during the study., Overall Response Rate (ORR) o ORR is defined as the proportion of participants with a CR or PR, as determined by the investigator., Complete Response (CR) rate o CR rate is defined as the proportion of participants with a best response of CR., Duration of Response (DoR) o The DoR is defined as the time from the date of first documented response (CR-PR) until the date of documented progression per the Lugano Classification for NHL or death (by any cause in the absence of disease progression), whichever occurs first., Time to Next Treatment (TTNT) o TTNT or death is defined as the time from the start of AVR induction until the start of the next anti-lymphoma therapy (including local radiotherapy, unless pre-planned at baseline) or death due to any cause, whichever comes first., Progression-free Survival (PFS) o PFS is defined as the time from the start of AVR induction until the date of documented objective disease progression or death (by any cause in the absence of progression), regardless of whether the participant withdraws from therapy or receives another anti-cancer therapy prior to progression., Event Free Survival (EFS) o EFS is defined as the time from the start of AVR induction to any of the following events: disease progression, or initiation of systemic anti-lymphoma treatment and or unplanned radiation, or death due to any cause, whichever occurs first., Overall Survival (OS) o OS is defined as the time from the start of AVR induction until death due to any cause., Post randomization time to first occurrence of relapse or death, EFS and TTNT in continued acalabrutinib arm compared to observation arm., o Time to first occurrence of relapse or death is defined as the time from Cycle 15 Day 1 until date of progression per the Lugano Classification for NHL as assessed by investigator, or death due to any cause, whichever occurs first., o Event-free survival is defined as the time from Cycle 15 Day 1 until any of the following events: disease progression, or initiation of subsequent systemic anti‑lymphoma treatment and/or unplanned radiation, or death due to any cause, whichever occurs first., o Time to next therapy or death is defined as the time from Cycle 15 Day 1 until the start of the next anti-lymphoma therapy (including local radiotherapy, unless pre-planned at baseline) or death due to any cause, whichever comes first., Number of participants with any Adverse Events (AE), Serious Adverse Events (SAE), Adverse Event of Special Interest (AESI) and AEs leading to study treatment discontinuation or dose modification, o Adverse events will be graded by the investigator according to the NCI-CTCAE v5.0. Each AE verbatim term will be coded to a system organ class and a preferred term using the MedDRA.

Source: https://euclinicaltrials.eu/ctis-public/view/2023-505205-16-00